EU clinical trial 2023-506134-79-00: A research study of a new medicine (NNC0650-0013) in healthy men
Protocol code: NN9650-5027
Sponsor: Novo Nordisk A/S (Pharmaceutical company). Phase: Human Pharmacology (Phase I)- First administration to humans. Countries: Germany (ended).
Therapeutic area(s): Diseases [C] - Nutritional and Metabolic Diseases [C18]
Gender: Male. Age: 18-64 years. Enrolment: 60.
Status: Ended. Start date (EU): 2024-01-23. End date (EU): 2024-05-07. Decision date: 2023-12-22. Results received: No. Last updated: 2023-12-22.

Condition(s): Weight management, Diabetes mellitus type 2; healthy subjects

Source: https://euclinicaltrials.eu/ctis-public/view/2023-506134-79-00